EU clinical trial 2023-508891-12-00: CRIMSON: A multicentre, randomised, sham-controlled (and active controlled in the USA), double-masked, 72 week trial to study the safety, tolerability, pharmacokinetics, and efficacy of 3 dosing regimens of intravitreal BI 764524 in patients with moderate to severe non-proliferative diabetic retinopathy
Protocol code: 1436-0007
Sponsor: Boehringer Ingelheim International GmbH (Pharmaceutical company). Phase: Therapeutic exploratory (Phase II). Countries: Hungary (ongoing, recruitment ended), Spain (ongoing, recruitment ended), Italy (ongoing, recruitment ended), Germany (ongoing, recruitment ended), Poland (ongoing, recruitment ended).
Therapeutic area(s): Diseases [C] - Eye Diseases [C11]
Gender: Female, Male. Age: 18-64 years, 65+ years. Enrolment: 103.
Status: Ongoing, recruitment ended. Start date (EU): 2024-11-28. Decision date: 2024-10-08. Results received: No. Last updated: 2026-07-14.
Decision dates by country: ES: 2024-10-08, PL: 2024-10-13, DE: 2024-10-10, HU: 2024-10-14, IT: 2024-10-11

Condition(s): Diabetic retinopathy
Product: BI 764524, Sham Injection Procedure

Primary endpoint: The primary endpoint is the occurrence of a ≥2 step improvement compared with baseline in DRSS level in the study eye at Week 52 as assessed by UWF-CFP images (within the 7-field grid).
Endpoint(s): The key secondary endpoint is the occurrence of VTCs, defined as PDR and/or anterior segment NV, or development of CI-DME, in the study eye between baseline and Week 52, Absolute change from baseline of BCVA [ETDRS letters] in the study eye at Week 52, Absolute change from baseline of central subfield thickness (CST) [μm], as assessed by spectral domain optical coherence tomography (SD-OCT), in the study eye at Week 52, Occurrence of a ≥2 step worsening of DRSS in the study eye between baseline and Week 52 as assessed by UWF-CFP images (within the 7-field grid), Occurrence of PDR and/or anterior segment NV in the study eye between baseline and Week 52, Occurrence of CI-DME in the study eye between baseline and Week 52, Occurrence of drug-related AEs between baseline and EOS, Occurrence of ocular AEs in the study eye between baseline and EOS, Occurrence of ocular AEs of special interest in the study eye between baseline and EOS

Source: https://euclinicaltrials.eu/ctis-public/view/2023-508891-12-00